EU clinical trial 2024-517486-16-00: The role of Contrast-Enhanced Spectral Mammography (CESM) in the diagnostic process of breast cancer: can it improve specificity of first-line examinations and therefore reduce the suspicious lesions that undergo vacuum assisted breast biopsy (VABB)?
Protocol code: IEO 960
Sponsor: Istituto Europeo Di Oncologia S.r.l. (Hospital/Clinic/Other health care facility). Phase: Therapeutic exploratory (Phase II). Countries: Italy (ongoing, recruiting).
Therapeutic area(s): Diseases [C] - Neoplasms [C04]
Gender: Female. Age: 18-64 years, 65+ years. Enrolment: 468.
Status: Ongoing, recruiting. Start date (EU): 2020-09-30. Decision date: 2024-10-14. Results received: No. Last updated: 2024-10-14.

Condition(s): Patients with breast lesions undergoing further examination
Product: Ultravist 370 mg/ml soluzione iniettabile

Primary endpoint: To evaluate the negative predictive value (NPV) of CESM comparison versus the NPV of the micro-histology or final histology (after surgery)
Endpoint(s): To establish CESM diagnostic performance in suspicious breast lesions using histology from VABB as gold standard correlating the definite result (after surgery) with preoperative imaging (accuracy).

Source: https://euclinicaltrials.eu/ctis-public/view/2024-517486-16-00